EU clinical trial 2024-513176-17-00: A Platform Study Evaluating the Efficacy and Safety of Investigational Therapies in Participants with Chronic Hepatitis B Infection (PREVAIL)
Protocol code: VIR-MHB1-V200
Sponsor: Vir Biotechnology Inc. (Pharmaceutical company). Phase: Therapeutic exploratory (Phase II). Countries: France (ended), Romania (ended).
Therapeutic area(s): Diseases [C] - Virus Diseases [C02]
Gender: Female, Male. Age: 18-64 years. Enrolment: 13.
Status: Ended. Start date (EU): 2023-03-30. End date (EU): 2025-08-19. Decision date: 2024-10-15. Results received: No. Last updated: 2025-09-03.
Decision dates by country: FR: 2024-10-16, RO: 2024-10-15

Condition(s): Chronic Hepatitis B Virus (HBV) Infection
Product: Pegasys 180 micrograms solution for injection in pre-filled syringe, VIR-3434, Viread 245 mg film-coated tablets, VIR-2218

Primary endpoint: • Proportion of participants achieving sustained suppression of HBV DNA (< LLOQ) with HBsAg loss (< 0.05 IU/mL) at 24 weeks after discontinuation of all treatment • Proportion of participants achieving sustained suppression of HBV DNA (< LLOQ) at 24 weeks after discontinuation of all treatment • Proportion of participants with HBsAg loss (< 0.05 IU/mL) at 24 weeks post-end of treatment, • Proportion of participants achieving suppression of HBV DNA (< LLOQ [lower limit of quantitation]) with HBsAg loss (< 0.05 IU/mL) at the end of treatment • Proportion of participants with HBsAg loss (< 0.05 IU/mL) at the end of treatment • Mean change in serum HBsAg from baseline across timepoints in the study
Endpoint(s): 1. Proportion of participants with treatment-emergent adverse events (TEAEs) and serious adverse events (SAEs) 2. Proportion of participants with serum HBsAg < 10 IU/mL at the end of treatment 3. Proportion of participants with serum HBsAg < 10 IU/mL at 24 weeks post-end of treatment 4. Serum HBsAg levels and change from baseline across timepoints in the study, 5. Serum HBsAg level at nadir during the study 6. Time to achieve nadir of serum HBsAg during the study 7. Time to achieve serum HBsAg loss (< 0.05 IU/mL) 8. Proportion of participants with HBsAg loss and anti-HBs seroconversion at end of treatment and at 24 weeks post-end of treatment

Source: https://euclinicaltrials.eu/ctis-public/view/2024-513176-17-00